EU clinical trial 2025-522686-29-00: A clinical trial comparing how the body takes up budesonide from different forms of medicine when taken by mouth with or without food.
Protocol code: BUL-011/BIO
Sponsor: Dr. Falk Pharma GmbH (Pharmaceutical company). Phase: Human Pharmacology (Phase I)- Other. Countries: Sweden (authorised, recruitment pending).
Therapeutic area(s): Diseases [C] - Digestive System Diseases [C06]; Diseases [C] - Immune System Diseases [C20]
Gender: Female, Male. Age: 18-64 years. Enrolment: 50.
Status: Authorised, recruitment pending. Decision date: 2026-07-07. Results received: No. Last updated: 2026-07-07.

Condition(s): Acute eosinophilic esophagitis

Source: https://euclinicaltrials.eu/ctis-public/view/2025-522686-29-00